EU clinical trial 2024-511055-17-00: A Randomized Parallel-group, Placebo-controlled, Double-blind, Eventdriven, Multi-center Phase 2 Clinical Outcome Trial of Prevention of Arteriovenous Graft Thrombosis and Safety of MK-2060 in Patients With End Stage Renal Disease Receiving Hemodialysis
Protocol code: MK-2060-007
Sponsor: Merck Sharp & Dohme LLC (Pharmaceutical company). Phase: Therapeutic exploratory (Phase II). Countries: Germany (ended), Czechia (ended), Greece (ended), Italy (ended), Portugal (ended), Bulgaria (ended), Romania (ended), Sweden (ended).
Therapeutic area(s): Diseases [C] - Cardiovascular Diseases [C14]
Gender: Female, Male. Age: 18-64 years, 65+ years. Enrolment: 93.
Status: Ended. Start date (EU): 2021-11-25. End date (EU): 2025-02-11. End date: 2025-02-13. Decision date: 2024-07-09. Results received: Yes. Last updated: 2024-10-25.
Decision dates by country: DE: 2024-07-11, GR: 2024-07-22, PT: 2024-07-10, RO: 2024-07-15, SE: 2024-07-09, CZ: 2024-07-10, IT: 2024-07-15, BG: 2024-07-12

Condition(s): Prevention of arteriovenous graft thrombosis
Product: MK-2060, Placebo to MK-2060

Primary endpoint: Time to First AVG Thrombosis Event
Endpoint(s): Time to Each Arteriovenous Graft Thrombosis Event (First and Recurrent), Number of Participants who Experience One or More Adverse Events (AEs), Number of Major Bleeding Events or Clinically Relevant Non-Major Bleeding Events per International Society on Thrombosis (ISTH) Criteria, Number of Participants Who Discontinue Study Intervention Due to an AE

Source: https://euclinicaltrials.eu/ctis-public/view/2024-511055-17-00